EU clinical trial 2025-520665-47-00: A Phase I/IIa Clinical Trial to Assess the Safety, Tolerability, and Efficacy of a Single Intravitreal Injection of SPVN20 Gene Therapy in Participants with Advanced Rod Cone Dystrophy
Protocol code: SPVN20-CLIN-01
Sponsor: Sparingvision (Pharmaceutical company). Phase: Human Pharmacology (Phase I)- First administration to humans. Countries: Belgium (ongoing, recruiting), France (ongoing, recruiting), Ireland (ongoing, recruiting).
Therapeutic area(s): Diseases [C] - Eye Diseases [C11]
Gender: Female, Male. Age: 18-64 years, 65+ years. Enrolment: 27.
Status: Ongoing, recruiting. Start date (EU): 2025-10-08. Decision date: 2025-05-27. Results received: No. Last updated: 2026-07-15.
Decision dates by country: IE: 2025-08-29, BE: 2025-05-27, FR: 2025-08-28

Condition(s): End-stage rod-cone dystrophy

Source: https://euclinicaltrials.eu/ctis-public/view/2025-520665-47-00